EU clinical trial 2024-513891-16-00: A study to assess the effect of gemfibrozil, itraconazole and phenytoin on levels of IPN60250 in the blood of healthy adult participant.
Protocol code: CLIN-60250-450
Sponsor: Ipsen Pharma (Pharmaceutical company). Phase: Human Pharmacology (Phase I)- Other. Countries: Germany (ended).
Therapeutic area(s): Not possible to specify
Gender: Female, Male. Age: 18-64 years. Enrolment: 60.
Status: Ended. Start date (EU): 2024-11-08. End date (EU): 2025-03-11. Decision date: 2024-10-10. Results received: No. Last updated: 2026-06-11.

Source: https://euclinicaltrials.eu/ctis-public/view/2024-513891-16-00